EU clinical trial 2024-511318-19-00: A Phase 2a, Double-Blinded, Randomized, Placebo-Controlled, and Active-Treatment Extension Study to Assess the Safety, Tolerability, Efficacy, Pharmacokinetics, and Immunogenicity of ARGX-119 in Participants With Amyotrophic Lateral Sclerosis
Protocol code: ARGX-119-2303
Sponsor: Argenx (Pharmaceutical company). Phase: Therapeutic exploratory (Phase II). Countries: Denmark (ended), France (ended), Netherlands (ended), Sweden (ended), Belgium (ended).
Therapeutic area(s): Diseases [C] - Nervous System Diseases [C10]
Gender: Female, Male. Age: 18-64 years, 65+ years. Enrolment: 49.
Status: Ended. Start date (EU): 2024-10-23. End date (EU): 2026-02-26. Decision date: 2024-09-23. Results received: No. Last updated: 2026-03-12.
Decision dates by country: BE: 2024-09-30, FR: 2024-09-27, NL: 2024-09-23, SE: 2024-09-27, DK: 2024-09-24

Condition(s): Amyotrophic Lateral Sclerosis (ALS)
Product: Placebo to ARGX-119 concentrate for solution for infusion, ARGX-119

Primary endpoint: Assessment of adverse events (AEs), Assessment of clinical laboratory tests, ECGs and vital signs
Endpoint(s): Rate of change from baseline to week 24 in electrophysiological muscle scan (MScan)-derived motor unit number (MUN), ARGX-119 pharmacokinetic (PK) parameters over time, Incidence of anti-drug antibodies (ADA) against ARGX-119 in serum over time, Prevalence of anti-drug antibodies (ADA) against ARGX-119 in serum over time

Source: https://euclinicaltrials.eu/ctis-public/view/2024-511318-19-00